EU clinical trial 2025-523525-17-00: C6461013 - An Interventional Open-label Phase 1b/2 Study to Evaluate Safety, Pharmacokinetics, and Preliminary Efficacy of PF-08634404 as Monotherapy and Combination Therapy in Adult Participants With Unresectable Locally Advanced or Metastatic Hepatocellular Carcinoma
Protocol code: C6461013
Sponsor: Pfizer Inc. (Pharmaceutical company). Phase: Phase I and Phase II (Integrated)- Other. Countries: Spain (authorised, recruitment pending), Italy (authorised, recruitment pending), Germany (authorised, recruitment pending), France (authorised, recruitment pending).
Therapeutic area(s): Diseases [C] - Neoplasms [C04]
Gender: Female, Male. Age: 18-64 years, 65+ years. Enrolment: 78.
Status: Authorised, recruitment pending. Decision date: 2026-04-09. Results received: No. Last updated: 2026-04-29.
Decision dates by country: DE: 2026-04-29, ES: 2026-04-10, FR: 2026-04-29, IT: 2026-04-09

Condition(s): Unresectable Locally Advanced or Metastatic Hepatocellular Carcinoma
Product: PF-08634404, YERVOY 5 mg/ml concentrate for solution for infusion

Primary endpoint: Phase 1b (Safety Run-In): AEs as characterized by type, frequency, severity (as graded by NCI CTCAE version 5.0), timing, seriousness, and relationship to study intervention., DLTs, Phase 2 (Dose Optimization/Expansion): Confirmed ORR per RECIST 1.1 by investigator., AEs as characterized by type, frequency, severity (as graded by NCI CTCAE version 5.0), timing, seriousness, and relationship to study intervention.
Endpoint(s): Phase 1b (Safety Run-In): Confirmed ORR per RECIST 1.1 by investigator, DOR per RECIST 1.1 by investigator, PFS per RECIST 1.1 by investigator, OS, Laboratory abnormalities as characterized by type, frequency, severity (as graded by NCI CTCAE version 5.0), and timing., Predose and/or postdose concentrations of PF-08634404, Incidence of ADA against PF-08634404, Phase 2 (Dose Optimization/Expansion): DOR per RECIST 1.1 by investigator, PFS per RECIST 1.1 by investigator, OS, Laboratory abnormalities as characterized by type, frequency, severity (as graded by NCI CTCAE version 5.0), and timing., Predose and/or postdose concentrations of PF-08634404., Incidence of ADA against PF-08634404.

Source: https://euclinicaltrials.eu/ctis-public/view/2025-523525-17-00